EU clinical trial 2022-500367-12-00: A Phase 3, Randomized, Double-Blind, Placebo-Controlled Study to Investigate the Efficacy and Safety of Oral Brepocitinib in Adults with Dermatomyositis
Protocol code: PVT-2201-301
Sponsor: Priovant Therapeutics Inc. (Pharmaceutical company). Phase: Therapeutic confirmatory (Phase III). Countries: Hungary (ended), Italy (ended), Czechia (ended), Slovakia, Netherlands (ongoing, recruitment ended), Spain (ended), Germany (ended), Bulgaria (ended), Romania (ended), Poland (ended), Belgium (ended), Portugal (ended).
Therapeutic area(s): Diseases [C] - Skin and Connective Tissue Diseases [C17]; Diseases [C] - Musculoskeletal Diseases [C05]
Gender: Female, Male. Age: 18-64 years, 65+ years. Enrolment: 126.
Start date (EU): 2022-11-30. Decision date: 2022-11-08. Results received: No. Last updated: 2026-07-23.
Decision dates by country: ES: 2022-11-11, SK: 2022-11-08, IT: 2022-11-10, CZ: 2022-11-10, BE: 2022-11-29, RO: 2022-11-10, PL: 2022-11-14, PT: 2023-08-07, HU: 2022-11-10, NL: 2022-11-10, BG: 2022-11-11, DE: 2022-11-10

Condition(s): Dermatomyositis
Product: Placebo for brepocitinib 25 mg, Placebo for brepocinib 5 mg, Brepocitinib, Brepocitinib

Primary endpoint: TIS at Week 52 TIS is a composite endpoint based on the following six Disease Activity CSM scores and ranges from 0 to 100 (2016 ACR /EULAR Myositis Response Criteria): PhGA-VAS; PtGA-VAS; MMT8 ;HAQ Disability Index; Muscle Enzyme Assessment, EMGA-VAS
Endpoint(s): Change from baseline in CDASI Activity Score at Week 52, DMOMS at Week 52 DMOMS is a composite endpoint based on the following four component measures and ranges from 0 to 100 [Pandya, 2024]: MMT-8; CDASI; PhGA-VAS; PtGA-VAS, The proportion of participants achieving TIS ≥ 40 points (moderate improvement) at Week 52, Time to achievement of consecutive (≥ 2 visits) TIS ≥ 40 points (moderate improvement) by Week 52, The proportion of participants, regardless of baseline corticosteroid use, achieving TIS ≥ 40 points (moderate improvement) at Week 52 with 0 to ≤ 2.5 mg/day of oral prednisone (or equivalent) at both Week 48 and Week 52, The proportion of participants achieving ≥ 40% improvement with a ≥ 4-point improvement from baseline in CDASI Activity Score at Week 52, The proportion of participants achieving TIS ≥ 60 points (major improvement) at Week 52, Change from baseline in HAQ-DI at Week 52, Change from baseline in CDASI Activity score at Week 4

Source: https://euclinicaltrials.eu/ctis-public/view/2022-500367-12-00